EU clinical trial 2023-506081-31-00: A randomised, double-blind, placebo-controlled trial of erythropoietin alfa versus placebo in mechanically ventilated critically ill patients following traumatic injury
Protocol code: UCDCRC/20/04
Sponsor: University College Dublin (Educational Institution). Phase: Therapeutic confirmatory (Phase III). Countries: Germany (ongoing, recruiting), Ireland (ongoing, recruiting), Finland (ongoing, recruiting), Slovenia (suspended), France (authorised, recruitment pending), Belgium (ongoing, recruiting).
Therapeutic area(s): Not possible to specify
Gender: Female, Male. Age: 18-64 years, 65+ years. Enrolment: 992.
Start date (EU): 2022-03-29. Decision date: 2024-05-17. Results received: No. Last updated: 2026-08-06.
Decision dates by country: SI: 2024-05-22, DE: 2024-05-22, IE: 2024-05-17, FI: 2024-05-20, BE: 2025-04-02, FR: 2024-07-02

Condition(s): Traumatic Injury
Product: EPREX 40000 UI/ml, solution injectable en seringue préremplie, Binocrit 40,000 IU/1 mL solution for injection in a pre-filled syringe, Epoetin alfa HEXAL 40,000 IU/1 mL solution for injection in a pre-filled syringe

Primary endpoint: Combination of Mortality and Severe Disability (defined as a WHODAS 2.0 score ≥25%) at six months
Endpoint(s): Six Month Mortality, ICU Mortality, Hospital Mortality, 28 Day Mortality, Dichotomised extended Glasgow Outcome Score Extended (GOSE) into favourable (i.e. >4) and unfavourable (i.e. <4) outcomes at six months, Proportion of participants with composite thrombotic vascular events (DVT, pulmonary embolism, myocardial infarction, cardiac arrest and cerebrovascular events) at 6 months.

Source: https://euclinicaltrials.eu/ctis-public/view/2023-506081-31-00